EU clinical trial 2026-525876-24-00: Phase I/II clinical trial on the use of central nervous system administrations of CART-NKG2D or NKIL15 cells in children, adolescent and young adults with recurrent/refractory high grade Central Nervous System tumours (CINK-CAR)
Protocol code: CINK-CAR
Sponsor: Hospital Universitario La Paz (Hospital/Clinic/Other health care facility). Phase: Phase I and Phase II (Integrated)- Other. Countries: Spain (authorised, recruitment pending).
Therapeutic area(s): Diseases [C] - Neoplasms [C04]
Gender: Female, Male. Age: 0-17 years, 18-64 years. Enrolment: 30.
Status: Authorised, recruitment pending. Decision date: 2026-07-15. Results received: No. Last updated: 2026-07-15.

Condition(s): Central nervous system tumours
Product: Unexpanded autologous peripheral blood adult differentiated NK cells stimulated with IL-15, CART45RA-NKG2D CELLS

Primary endpoint: Incidence and severity and relatedness of adverse reactions. Incidence of SAEs. Changes of performance status over time. Incidence of IMP-related Grade ≥3 toxicities at day 48. Incidence and grade of CRS (ASTCT) and neurotoxicity/ICANS, including need for ICU, tocilizumab, corticosteroids.
Endpoint(s): Progression-free survival (PFS): defined as the time from treatment initiation to disease progression or death from any cause, assessed according to RAPNO and iRECIST criteria. PFS rates will be estimated at 3, 6, and 12 months., Overall survival (OS): defined as the time from treatment initiation to death from any cause. OS rates will be evaluated at 3, 6, and 12 months., Objective response rate (ORR): defined as the proportion of patients achieving complete response (CR) or partial response (PR) according to RAPNO and iRECIST criteria., Duration of response (DoR), defined as the time from the first documented objective response (complete response or partial response according to RAPNO and iRECIST criteria) until disease progression or death from any cause, whichever occurs first., Proportion of patients for whom successful manufacturing of NKIL15 or NKG2D-CAR T cells is achieved, defined as production of sufficient cell doses to complete the planned two treatment courses., Detection rate of tumour-derived cells in CSF at scheduled study assessments., Detection and persistence of NKIL15 cells and NKG2D-CAR T cells in CSF during scheduled assessments., Quantification of cytokine levels in CSF samples collected according to the schedule of assessments.

Source: https://euclinicaltrials.eu/ctis-public/view/2026-525876-24-00